EU clinical trial 2025-525091-29-00: SISTAR: Stratifying Immunosuppression to Allogenic Risk. A randomized, open label, assessor blinded, controlled, non-inferiority, safety study of half- vs standard dose immunosuppression in kidney transplant recipients with a well-matched donor.
Protocol code: SISTAR
Sponsor: Medical University Of Vienna (Educational Institution). Phase: Therapeutic exploratory (Phase II). Countries: Austria (authorised, recruitment pending).
Therapeutic area(s): Analytical,Diagnostic,Therapeutic Techniques and Equipment [E]-Surgical Procedures, Operative [E04]; Analytical, Diagnostic and Therapeutic Techniques and Equipment [E] - Investigative Techniques [E05]
Gender: Female, Male. Age: 18-64 years, 65+ years. Enrolment: 120.
Status: Authorised, recruitment pending. Decision date: 2026-05-17. Results received: No. Last updated: 2026-05-17.

Condition(s): Kidney Transplant Recipient
Product: NULOJIX 250 mg powder for concentrate for solution for infusion

Primary endpoint: Biopsy-proven rejection (Banff ≥1A) within the one-year intervention phase (V5-V17), Occurrence of dnDSAs (MFI>1000) within the one-year intervention phase (V5-V17)
Endpoint(s): eGFR levels after the one-year intervention phase, Incidence of ddcfDNA > 1% within the one-year intervention phase, Graft loss within the one-year intervention phase: Graft loss is defined as permanent (>3 months) return to dialysis or re-transplantation., Incidence rate of infections within the one-year intervention phase, Mortality within the one-year intervention phase

Source: https://euclinicaltrials.eu/ctis-public/view/2025-525091-29-00